EU clinical trial 2023-508808-38-00: Phase 1, First-in-Human Study to Assess the Safety, Tolerability and Anti-tumor Activity of CDR404 in HLA-A*02:01 Participants with MAGE-A4 Expressing Solid Tumors
Protocol code: CDR404-001
Sponsor: CDR-Life AG (Pharmaceutical company). Phase: Human Pharmacology (Phase I)- First administration to humans. Countries: Denmark (ongoing, recruiting), Belgium (ongoing, recruiting), Italy (ongoing, recruiting), Spain (ongoing, recruiting).
Therapeutic area(s): Diseases [C] - Neoplasms [C04]
Gender: Female, Male. Age: 18-64 years, 65+ years. Enrolment: 58.
Status: Ongoing, recruiting. Start date (EU): 2024-05-29. Decision date: 2024-04-28. Results received: No. Last updated: 2026-06-26.
Decision dates by country: DK: 2024-04-28, BE: 2024-06-28, IT: 2024-07-31, ES: 2024-06-18

Condition(s): Solid tumors

Source: https://euclinicaltrials.eu/ctis-public/view/2023-508808-38-00